EU clinical trial 2023-506778-11-00: I3Y-MC-JPCS: A Phase 1b/2 Study of Abemaciclib in Combination with Irinotecan and Temozolomide (Part A) and Abemaciclib in Combination with Temozolomide (Part B) in Pediatric and Young Adult Patients with Relapsed/Refractory Solid Tumors and Abemaciclib in Combination with Dinutuximab, GM-CSF, Irinotecan, and Temozolomide in Pediatric and Young Adult Patients with Relapsed/Refractory Neuroblastoma (Part C).
Protocol code: I3Y-MC-JPCS
Sponsor: Eli Lilly & Co. (Pharmaceutical company). Phase: Phase I and Phase II (Integrated)- Other. Countries: Spain (ended).
Therapeutic area(s): Diseases [C] - Neoplasms [C04]
Gender: Female, Male. Age: 0-17 years, 18-64 years. Enrolment: 26.
Status: Ended. Start date (EU): 2020-11-11. End date (EU): 2025-08-19. Decision date: 2024-04-08. Results received: Yes. Last updated: 2025-05-27.

Condition(s): Relapsed/Refractory Solid Tumors
Product: Abemaciclib, TEMOZOLOMIDE, Verzenios 50 mg film-coated tablets, IRINOTECAN

Primary endpoint: Dose Limiting Toxicity (DLT), Maximum Tolerated Doses (MTD), PK (plasma concentrations of abemaciclib, irinotecan, and temozolomide)

Source: https://euclinicaltrials.eu/ctis-public/view/2023-506778-11-00